EU clinical trial 2023-509276-42-00: An open label, multi-center roll-over study to assess longterm effect in pediatric patients treated with Tafinlar (dabrafenib) and/or Mekinist (trametinib)
Protocol code: CDRB436G2401
Sponsor: Novartis Pharma AG (Pharmaceutical company). Phase: Therapeutic use (Phase IV). Countries: Czechia (ongoing, recruitment ended), France (ongoing, recruitment ended), Sweden (ended), Germany (ongoing, recruitment ended), Denmark (ongoing, recruitment ended), Finland (ongoing, recruitment ended), Netherlands (ended), Italy (ongoing, recruitment ended), Belgium (ended), Spain (ongoing, recruitment ended).
Therapeutic area(s): Diseases [C] - Neoplasms [C04]
Gender: Female, Male. Age: 0-17 years, 18-64 years. Enrolment: 68.
Start date (EU): 2019-10-30. Decision date: 2024-07-19. Results received: No. Last updated: 2026-07-30.
Decision dates by country: NL: 2024-07-19, CZ: 2024-07-24, FI: 2024-07-23, DK: 2024-07-25, BE: 2024-07-23, ES: 2024-07-24, IT: 2024-08-05, DE: 2024-07-23, SE: 2024-07-22, FR: 2024-07-23

Condition(s): Children and Adolescents with Cancers Harboring V600 mutation.
Product: TMT212, Mekinist 0.5 mg film-coated tablets, Mekinist, Mekinist 2 mg film-coated tablets, DRB436, DRB436, DRB436, TMT212

Primary endpoint: AEs, SAE, clinically significant changes in laboratory values and vital signs.
Endpoint(s): Serial measurements of height, weight, skeletal maturation, sexual maturation and cardiac function., Disease specific clinical benefit, as determined by investigator using institutional standard of care.

Source: https://euclinicaltrials.eu/ctis-public/view/2023-509276-42-00